EU clinical trial 2024-514891-41-00: A post-trial access roll-over study to allow access to ribociclib (LEE011) for patients who are on ribociclib treatment in Novartis-sponsored study
Protocol code: CLEE011A2412B
Sponsor: Novartis Pharma AG (Pharmaceutical company). Phase: Therapeutic use (Phase IV). Countries: Italy (ended), Greece (ended), Poland (ongoing, recruitment ended), Portugal (ongoing, recruitment ended), Spain (ongoing, recruitment ended).
Therapeutic area(s): Diseases [C] - Neoplasms [C04]
Gender: Female, Male. Age: 18-64 years, 65+ years. Enrolment: 7.
Start date (EU): 2022-07-19. Decision date: 2024-08-05. Results received: No. Last updated: 2026-06-03.
Decision dates by country: GR: 2024-08-22, PL: 2024-08-07, IT: 2024-08-09, ES: 2024-08-05, PT: 2024-08-07

Condition(s): HR+, HER2- advanced or metastatic breast cancer
Product: LETROZOLE, RIBOCICLIB, GOSERELIN ACETATE, LEE011, TAMOXIFEN

Primary endpoint: Frequency and severity of AEs/SAEs, Proportion of participants with clinical benefit as assessed by the Investigator

Source: https://euclinicaltrials.eu/ctis-public/view/2024-514891-41-00